EU clinical trial 2025-523495-23-00: RASolute 304: A Phase 3 Multicenter, Open-label, Randomized, 2‑Arm Study of Adjuvant Daraxonrasib Versus Standard of Care Observation Following Completion of Neoadjuvant and/or Adjuvant Chemotherapy in Patients with Resected Pancreatic Ductal Adenocarcinoma (PDAC)
Protocol code: RMC-6236-304
Sponsor: Revolution Medicines Inc. (Pharmaceutical company). Phase: Therapeutic confirmatory (Phase III). Countries: France (ongoing, recruiting), Spain (ongoing, recruiting), Italy (ongoing, recruiting), Germany (ongoing, recruiting).
Therapeutic area(s): Diseases [C] - Digestive System Diseases [C06]
Gender: Female, Male. Age: 18-64 years, 65+ years. Enrolment: 98.
Status: Ongoing, recruiting. Start date (EU): 2026-06-09. Decision date: 2026-04-27. Results received: No. Last updated: 2026-05-04.
Decision dates by country: FR: 2026-04-28, DE: 2026-04-27, IT: 2026-04-28, ES: 2026-05-04

Condition(s): Resected Pancreatic Ductal Adenocarcinoma (PDAC)
Product: DARAXONRASIB (RMC-6236), DARAXONRASIB (RMC-6236)

Primary endpoint: Disease-Free Survival (DFS) per Investigator DFS defined as the time from randomization until disease recurrence or death from any cause, whichever occurs first. Recurrence is per response evaluation criteria in solid tumors (RECIST) v1.1 as assessed by Investigator.
Endpoint(s): Overall survival (OS) - OS is defined as the time from randomization until death from any cause, DFS per blinded independent central review (BICR) - DFS defined as the time from randomization until disease recurrence or death from any cause, whichever occurs first. Recurrence is per RECIST v1.1 as assessed by BICR, DFS Rate at 1 year and 2 years - DFS rate defined as percentage of patients who are disease free at 1 year and 2 years, respectively, OS rate at 1 year and 2 years - OS rate defined as percentage of patients who are alive at 1 year and 2 years, respectively., Safety and tolerability of daraxonrasib - Incidence of adverse events (AEs) and changes from baseline in vital signs, ECOG performance score, and clinical laboratory tests, Pharmacokinetics (PK) - Predose concentration of daraxonrasib

Source: https://euclinicaltrials.eu/ctis-public/view/2025-523495-23-00